EU clinical trial 2024-513014-35-00: A PHASE III, MULTICENTER, DOUBLE-BLIND, PLACEBO-CONTROLLED, TREAT-THROUGH STUDY TO ASSESS THE EFFICACY AND SAFETY OF INDUCTION AND MAINTENANCE THERAPY WITH RO7790121 IN PATIENTS WITH MODERATELY TO SEVERELY ACTIVE ULCERATIVE COLITIS
Protocol code: GA45329
Sponsor: F. Hoffmann-La Roche AG (Pharmaceutical company). Phase: Therapeutic confirmatory (Phase III). Countries: Poland (ongoing, recruitment ended), Austria (ended), Denmark (ended), Germany (ongoing, recruitment ended), Croatia (ongoing, recruitment ended), Belgium (ongoing, recruitment ended), Netherlands (ended), Romania (ended), Slovakia (ongoing, recruitment ended), Spain (ongoing, recruitment ended), Italy (ongoing, recruitment ended), Hungary (ongoing, recruitment ended), Czechia (ongoing, recruitment ended), France (ongoing, recruitment ended), Bulgaria (ongoing, recruitment ended), Portugal (ongoing, recruitment ended).
Therapeutic area(s): Diseases [C] - Digestive System Diseases [C06]; Phenomena and Processes [G] - Immune System Phenomena [G13]
Gender: Female, Male. Age: 18-64 years, 65+ years. Enrolment: 348.
Start date (EU): 2024-11-13. Decision date: 2024-11-11. Results received: No. Last updated: 2026-06-08.
Decision dates by country: DK: 2024-11-12, NL: 2024-11-22, BE: 2024-11-11, SK: 2024-12-02, PT: 2024-11-14, DE: 2024-11-12, FR: 2024-11-18, IT: 2024-11-14, ES: 2024-11-29, RO: 2024-11-22, PL: 2024-11-18, CZ: 2024-11-14, AT: 2024-11-18, HU: 2024-11-14, BG: 2024-11-14, HR: 2024-11-19

Condition(s): Moderately to Severely Active Ulcerative Colitis (UC)

Primary endpoint: Clinical remission, defined as mMS ≤ 2 with stool frequency subscore (SFS) = 0 or 1, rectal bleeding subscore (RBS) = 0, and ES = 0 or 1, at Week 12 and at week 52
Endpoint(s): Stool frequency Subscore (SFS) from baseline to Week 12, Rectal Bleeding Subscore (RBS) from baseline to Week 12, Partial modified Mayo Score (pmMS), defined as SFS + RBS, from baseline to Week 12, Symptomatic response, defined as a decrease in pmMS of at least 1 point and 30% from baseline, at Week 12, Endoscopic improvement, defined as ES = 0 or 1, at Week 12, - Endoscopic remission, defined as ES = 0, at Week 12, - Clinical response, defined as a decrease in mMS of at least 2 points and 30% from baseline and either a decrease in RBS ≥ 1 or RBS = 0 or 1, at Week 12, Histologic improvement, defined as Geboes ≤ 3.1 at Week 12, Histologic remission, defined as Geboes < 2B at Week 12, Histologic-endoscopic mucosal improvement, defined as Geboes ≤ 3.1 and ES = 0 or 1, at Week 12, Histologic-endoscopic remission, defined as Geboes < 2B and ES = 0 or 1, at Week 12, Maintenance of remission, defined as clinical remission at both Weeks 12 and 52, Corticosteroid-free remission, defined as clinical remission at Week 52 and no use of corticosteroids for UC at least 8 weeks prior to Week 52, Endoscopic improvement at Week 52, Endoscopic remission at Week 52, Histologic improvement at Week 52, Histologic remission at Week 52, Histologic-endoscopic mucosal improvement at Week 52, Histologic-endoscopic remission at Week 52, Among biomarker-defined subgroups of participants: Clinical remission at Week 12, Among biomarker-defined subgroups of participants: Clinical remission at Week 52, Among biomarker-defined subgroups of participants: Endoscopic improvement at Week 12, Among biomarker-defined subgroups of participants: Endoscopic improvement at Week 52, Bowel urgency from baseline through Week 52, Abdominal pain from baseline through Week 52, Fatigue, as measured by Functional Assessment of Chronic Illness Therapy-Fatigue (FACIT-F), from baseline to Week 12 and Week 52, Inflammatory Bowel Disease Questionnaire (IBDQ) from baseline to Week 12 and Week 52, Overall change in UC symptoms, as measured by Patient Global Impression of Change (PGIC), from baseline to Week 2, Week 12, and Week 52, Overall severity in UC symptoms, as measured by Patient Global Impression of Severity (PGIS), from baseline to Week 2, Week 12, and Week 52, Incidence and severity of adverse events, Incidence and severity of serious adverse events, Incidence and severity of adverse events leading to study treatment discontinuation, Incidence and severity of adverse events of special interest

Source: https://euclinicaltrials.eu/ctis-public/view/2024-513014-35-00